EU clinical trial 2023-509810-13-00: B1931036 - A PROSPECTIVE, RANDOMIZED, OPEN-LABEL PHASE 2 STUDY TO EVALUATE THE SUPERIORITY OF INOTUZUMAB OZOGAMICIN MONOTHERAPY VERSUS ALLR3 FOR INDUCTION TREATMENT OF CHILDHOOD HIGH- RISK OR VERY HIGH-RISK FIRST RELAPSE B-CELL PRECURSOR ACUTE LYMPHOBLASTIC LEUKAEMIA
Protocol code: B1931036
Sponsor: Pfizer Inc. (Pharmaceutical company). Phase: Therapeutic exploratory (Phase II). Countries: Sweden (ongoing, recruiting), Norway (ongoing, recruiting), Greece (ended), Finland (ongoing, recruiting), Austria (authorised, recruiting), Poland (ended), Hungary (ended), Denmark (ongoing, recruiting), Netherlands (authorised, recruiting), Czechia (ongoing, recruiting), Germany (ongoing, recruiting), Spain (ongoing, recruiting), Slovakia (ongoing, recruiting), France (ongoing, recruiting), Belgium (ongoing, recruiting), Italy (ongoing, recruiting).
Therapeutic area(s): Diseases [C] - Neoplasms [C04]
Gender: Female, Male. Age: 0-17 years. Enrolment: 91.
Start date (EU): 2023-05-13. Decision date: 2024-08-13. Results received: No. Last updated: 2026-07-20.
Decision dates by country: GR: 2024-08-22, HU: 2024-08-14, PL: 2024-09-24, AT: 2024-09-29, FR: 2024-08-22, NO: 2024-08-15, ES: 2024-08-13, DE: 2024-08-26, DK: 2024-08-20, CZ: 2024-08-14, SE: 2024-08-13, IT: 2024-10-02, BE: 2024-09-30, FI: 2024-08-14, SK: 2024-08-15, NL: 2024-08-14

Condition(s): Acute Lymphoblastic Leukemia (ALL)
Product: Dexamethason 0,5 mg JENAPHARM®, Dexamethason 4 mg JENAPHARM®, Dexamethasone Tablets BP 2.0mg, Vincristine Sulfate 1 mg/ml solution for injection, BESPONSA 1 mg powder for concentrate for solution for infusion, MITOXANTRONE HYDROCHLORIDE, CRISANTASPASE, Oncaspar 750 U/ml powder for solution for injection/infusion., DEXAMETHASONE SODIUM PHOSPHATE

Primary endpoint: Minimal residual disease (MRD)-negative, CR/CRp/CRi (per investigator assessment) at the end of induction therapy (MRD negativity is assessed by central lab and defined as leukemic blasts <1x10-4 by real time quantitative polymerase chain reaction (RQ-PCR) [with reflex to FC result if MRD is non-evaluable by RQ-PCR]).
Endpoint(s): EFS, defined as the time from randomization until objective progression, relapse from CR/CRp/CRi, based on investigator assessment per response criteria, failure to achieve CR/CRp/CRi by the end of induction, MRD persistence prior to HSCT, second malignancy, or death due to any cause., DOR, defined as time from date of first documented response (CR/CRp/CRi) to the date of first documented objective progression, relapse from CR/CRp/CRi as determined by investigator assessment per modified NCCN response criteria, MRD persistence prior to HSCT, or death due to any cause, whichever occurs first., HSCT (and CAR T-cell therapy) rate, defined as the number and percentage of participants being transplanted and those receiving CAR Tcell therapy after treatment with InO or ALLR3., OS, defined as the time from the date of randomization to the date of death due to any cause., Incidence and severity of AEs graded per NCI CTCAE v4.03., Cmax and Ctrough

Source: https://euclinicaltrials.eu/ctis-public/view/2023-509810-13-00